EU clinical trial 2023-507667-19-00: Study to evaluate the pharmacokinetics, safety and tolerability of Secukinumab in patients with GCA or PMR
Protocol code: CAIN457E22101
Sponsor: Novartis Pharma AG (Pharmaceutical company). Phase: Human Pharmacology (Phase I)- Other. Countries: Spain (ended), Czechia (ended), Portugal (ended), Italy (ended).
Therapeutic area(s): Diseases [C] - Musculoskeletal Diseases [C05]
Gender: Female, Male. Age: 18-64 years, 65+ years. Enrolment: 24.
Status: Ended. Start date (EU): 2024-06-06. End date (EU): 2025-04-02. End date: 2025-04-03. Decision date: 2024-05-03. Results received: No. Last updated: 2025-02-14.
Decision dates by country: CZ: 2024-05-03, IT: 2024-05-03, PT: 2024-05-06, ES: 2024-05-03

Condition(s): Polymyalgia rheumatica (PMR), Giant cell arteritis (GCA)

Source: https://euclinicaltrials.eu/ctis-public/view/2023-507667-19-00